EU clinical trial 2024-515028-35-00: RHIBOT II - Medium- and long-term efficacy of two ultrasound-guided intra-articular injections of onabotulinumtoxinA (Botox®) combined with custom-made rigid splinting in painful base-of-thumb osteoarthritis : a randomized double-blind controlled trial in three-parallel arms
Protocol code: APHP230823
Sponsor: Assistance Publique Hopitaux De Paris (Hospital/Clinic/Other health care facility). Phase: Therapeutic confirmatory (Phase III). Countries: France (ongoing, recruiting).
Therapeutic area(s): Diseases [C] - Musculoskeletal Diseases [C05]
Gender: Female, Male. Age: 18-64 years, 65+ years. Enrolment: 120.
Status: Ongoing, recruiting. Start date (EU): 2025-12-03. Decision date: 2025-01-24. Results received: No. Last updated: 2025-11-25.

Condition(s): Adults aged at least 18 years with painful base-of-thumb osteoarthritis
Product: BOTOX 50 UNITÉS ALLERGAN, poudre pour solution injectable, SODIUM CHLORIDE

Primary endpoint: The primary efficacy end point will be mean change from baseline in base-of-thumb pain on the painful side (either left or right) in the 48h previous to the interview on a self-administered 11-point numeric rating scale at 6 months after the first intra-articular injection, analysed by intention to treat.

Source: https://euclinicaltrials.eu/ctis-public/view/2024-515028-35-00